EU clinical trial 2023-505479-56-00: A Study to Assess the Adverse Events, Change in Disease Activity, and How Intravenously Infused ABBV-319 Moves Through the Bodies of Adult Participants With Relapsed or Refractory (R/R) Diffuse Large B-cell Lymphoma (DLBCL), Follicular Lymphoma (FL), or Chronic Lymphocytic Leukemia (CLL)
Protocol code: M22-716
Sponsor: AbbVie Deutschland GmbH & Co. KG (Pharmaceutical company). Phase: Human Pharmacology (Phase I)- First administration to humans. Countries: Italy (ended), France (ended), Spain (ongoing, recruitment ended).
Therapeutic area(s): Diseases [C] - Neoplasms [C04]
Gender: Female, Male. Age: 18-64 years, 65+ years. Enrolment: 44.
Start date (EU): 2025-07-30. Decision date: 2025-07-14. Results received: No. Last updated: 2026-04-17.
Decision dates by country: IT: 2025-07-14, FR: 2025-07-17, ES: 2025-07-16

Condition(s): Follicular lymphoma (FL), Chronic lymphocytic leukemia (CLL), Diffuse large b-cell lymphoma (DLBCL), B-cell malignancies

Source: https://euclinicaltrials.eu/ctis-public/view/2023-505479-56-00